EU clinical trial 2023-504740-33-00: A Phase 3, Randomized, Placebo-controlled, Parallel-group, Multicenter Study to Evaluate the Efficacy and Safety of Guselkumab in Participants with Fistulizing, Perianal Crohn’s Disease
Protocol code: CNTO1959CRD3005
Sponsor: Janssen - Cilag International (Pharmaceutical company). Phase: Therapeutic confirmatory (Phase III). Countries: Portugal (ongoing, recruitment ended), Spain (ongoing, recruitment ended), Germany (ongoing, recruitment ended), Poland (ongoing, recruitment ended), Belgium (ended), Netherlands (ended), Hungary (ongoing, recruitment ended), Czechia (ongoing, recruitment ended), Italy (ongoing, recruitment ended), France (ongoing, recruitment ended), Greece (ongoing, recruitment ended).
Therapeutic area(s): Diseases [C] - Immune System Diseases [C20]
Gender: Female, Male. Age: 18-64 years, 65+ years. Enrolment: 190.
Start date (EU): 2022-11-22. Decision date: 2024-08-13. Results received: No. Last updated: 2026-07-24.
Decision dates by country: HU: 2024-08-14, BE: 2024-08-13, NL: 2024-08-14, IT: 2024-09-02, CZ: 2024-08-14, FR: 2024-09-13, DE: 2024-08-16, GR: 2024-11-01, PL: 2024-08-29, PT: 2024-08-14, ES: 2024-08-13

Condition(s): Fistulizing perianal Crohn's Disease
Product: Placebo to Guselkumab- Solution for infusion- 10 mg/ml, Placebo to Guselkumab, Placebo to Guselkumab solution for injection in pre-filled syringe -100 mg/ml, Guselkumab - solution for injection in pre-filled syringe - 100 mg/mL, Guselkumab- Solution for infusion- 10 mg/ml, Guselkumab

Primary endpoint: The primary endpoint of this study is the proportion of participants who achieve combined fistula remission at Week 24

Source: https://euclinicaltrials.eu/ctis-public/view/2023-504740-33-00